EU clinical trial 2024-515110-40-00: DupuytrEn Treatment EffeCtiveness Trial (DETECT): a protocol for prospective, randomized, controlled, outcome assessor-blinded, three armed parallel 1:1:1, multicenter trial comparing efficacy and cost effectiveness of collagenase clostridium histolyticum, percutaneous needle fasciotomy and limited fasciectomy as a short and long term treatment strategy in mild or moderate Dupuytren’s contracture
Protocol code: DETECT
Sponsor: Pirkanmaan hyvinvointialue (Hospital/Clinic/Other health care facility). Phase: Therapeutic confirmatory (Phase III). Countries: Finland (ongoing, recruitment ended).
Therapeutic area(s): Diseases [C] - Skin and Connective Tissue Diseases [C17]; Diseases [C] - Musculoskeletal Diseases [C05]
Gender: Female, Male. Age: 18-64 years, 65+ years. Enrolment: 50.
Status: Ongoing, recruitment ended. Start date (EU): 2017-09-15. Decision date: 2024-09-03. Results received: No. Last updated: 2026-05-20.

Condition(s): Dupuytren's contracture
Product: COLLAGENASE

Primary endpoint: Success at five years

Source: https://euclinicaltrials.eu/ctis-public/view/2024-515110-40-00